EU clinical trial 2023-507370-41-00: Randomized, controlled, open-label, multi-center trial to compare the efficacy and safety of three herbal medicinal products in the treatment of acute bronchitis
Protocol code: EA-20-01-032
Sponsor: Engelhard Arzneimittel GmbH & Co. KG (Pharmaceutical company). Phase: Therapeutic use (Phase IV). Countries: Germany (ended).
Therapeutic area(s): Diseases [C] - Respiratory Tract Diseases [C08]
Gender: Female, Male. Age: 18-64 years, 65+ years. Enrolment: 300.
Status: Ended. Start date (EU): 2024-02-14. End date (EU): 2024-04-26. Decision date: 2024-02-13. Results received: Yes. Last updated: 2024-04-03.
Decision dates by country: DE: 2024-04-03

Condition(s): Acute bronchitis
Product: Bronchicum Tropfen 43,4 g Thymiankraut-Fluidextrakt und 21,7 g Primelwurzeltinktur / 100 ml Flüssigkeit, Bronchipret® Tropfen Flüssigkeit zum Einnehmen Wirkstoffe: Fluidextrakt aus Thymiankraut Fluidextrakt aus Efeublättern, Prospan® Hustentropfen

Primary endpoint: Change of BSS between visit V1 (baseline) and visit V6 (7 days of treatment)
Endpoint(s): Change of BSS between visit V1 (baseline) and each post-baseline visit V2, V3, V4, V5, V7, and V8 as well as baseline adjusted AUC, BSS at each post-baseline visits V2 to V8 and change of BSS between visit V1 (baseline) and post-baseline visits V2, V3, V4, V5, V7, and V8, and related AUCs, CS assessed on VAS between visit V1 (baseline) and post-baseline visits (Area under the curve (AUC) generated with VAS values between visit V1 (baseline) and post-baseline visits V2, V3, V4, V5, V6, V7, and V8 as well as baseline adjusted AUC), CS assessed on VAS at each post-baseline visit and change of CS-VAS between visit V1 (baseline) and post-baseline visits, and related AUCs., Change in CS assessed by VCD score between visit V1 (baseline) and each post-baseline visit V2, V3, V4, V5, V6, V7, and V8, Global efficacy (scores of a 5-point Likert scale by patient and investigator) at post-baseline visits V6, V7 and V8

Source: https://euclinicaltrials.eu/ctis-public/view/2023-507370-41-00